EU clinical trial 2023-507547-11-00: A randomized, double-blind, placebo-controlled, single and multiple-dose-escalation, phase 1 study in healthy volunteers and patients with ulcerative colitis to evaluate the safety, tolerability, pharmacokinetics, and pharmacodynamics of GRT-001 (MONOlith trial)
Protocol code: GRT-1C101
Sponsor: Granite Bio AG (Pharmaceutical company). Phase: Human Pharmacology (Phase I)- First administration to humans. Countries: Germany (ongoing, recruiting).
Therapeutic area(s): Diseases [C] - Digestive System Diseases [C06]
Gender: Female, Male. Age: 18-64 years, 65+ years. Enrolment: 112.
Status: Ongoing, recruiting. Start date (EU): 2024-02-09. Decision date: 2024-01-11. Results received: No. Last updated: 2026-07-14.

Condition(s): Ulcerative colitis

Source: https://euclinicaltrials.eu/ctis-public/view/2023-507547-11-00